EU clinical trial 2024-518523-30-00: A Phase 2b, Multicenter, Randomized, Placebo-controlled, Double-blind Study to Assess the Safety and Efficacy of AD04 in Patients with Early Alzheimer’s Disease - ADVANCE
Protocol code: ADVANCE-AD04-001
Sponsor: Advantage Therapeutics GmbH (Pharmaceutical company). Phase: Therapeutic exploratory (Phase II). Countries: Poland (temporarily halted), Austria (temporarily halted).
Therapeutic area(s): Diseases [C] - Nervous System Diseases [C10]
Gender: Female, Male. Age: 18-64 years, 65+ years. Enrolment: 58.
Status: Temporarily halted. Start date (EU): 2023-11-08. Decision date: 2024-12-15. Results received: No. Last updated: 2025-01-30.
Decision dates by country: AT: 2024-12-15, PL: 2024-12-16

Condition(s): early Alzheimer’s disease
Product: PBS Solution, AD04

Primary endpoint: Composite score assessing cognition [adapted AD Assessment Scale cognitive (aADAS-cog)], daily function [adapted AD Cooperative Study Activities of Daily Living (aADCS-ADL)] and CDR-sb over 6 months measured in overall time saved with treatment
Endpoint(s): Safety Endpoints - Incidence of treatment-emergent adverse events (TEAEs), Key Secondary Efficacy Endpoint - Change from baseline in Clinical Dementia Rating - sum of boxes (CDRsb)., Other Secondary Efficacy Endpoints (I-III) - I. Global statistical test (GST) combining cognition [ADAS-cog] and daily function [ADCS-ADL] II. Change from baseline in hippocampal volume (total, right, and left), measured by volumetric Magnetic Resonance Imaging (MRI) III. Change from baseline in cognition score (ADAS-cog and aADAS-cog)., Other Secondary Efficacy Endpoints (IV-VII) - IV. Change from baseline in function score (ADCS-ADL and aADCS-ADL) V. Neuropsychiatric inventory (NPI) VI. Clinician’s Global Impressions of Change (CGIC) VII. Assessment of Quality of Life in patients with AD and their caregivers (QOL-AD), Exploratory endpoints – 1. Concentrations of aluminium in the blood, cerebrospinal fluid (CSF), and urine for pharmacokinetic profiling of AD04 (AUC and cumulative maximum concentration adjusted for pre-dose baseline values) 2. Levels of circulating biomarkers 3. PK/PD relationships

Source: https://euclinicaltrials.eu/ctis-public/view/2024-518523-30-00